EU clinical trial 2023-507030-24-00: A Randomized, Multicenter, Double-Masked, Vehicle-Controlled Phase 2 Study to Evaluate the Safety and Efficacy of NEXAGON ® (Lufepirsen Ophthalmic Gel) in Subjects with Persistent Corneal Epithelial Defects (NEXPEDE-1)
Protocol code: GLK-601-01AMB-01-006
Sponsor: Glaukos Corp. (Pharmaceutical company). Phase: Therapeutic exploratory (Phase II). Countries: Italy (ongoing, recruiting), Spain (ongoing, recruiting), Germany (ongoing, recruiting), France (authorised, recruitment pending).
Therapeutic area(s): Diseases [C] - Eye Diseases [C11]
Gender: Female, Male. Age: 18-64 years, 65+ years. Enrolment: 84.
Start date (EU): 2025-04-30. Decision date: 2024-04-04. Results received: No. Last updated: 2026-07-13.
Decision dates by country: ES: 2024-04-04, DE: 2024-04-05, FR: 2026-07-08, IT: 2024-04-08

Condition(s): Persistent Corneal Epithelial Defects
Product: NEXAGON vehicle: sterile formulated, thermoreversible gel without the API (lufepirsen). It contains poloxamer 407, sodium phosphate dibasic heptahydrate, potassium dihydrogen phosphate, and sterile water for injection, NEXAGON, NEXAGON

Primary endpoint: The proportion of subjects achieving corneal re-epithelialization that is maintained for a minimum of 28 days, based on assessment of corneal fluorescein staining images of the PCED by a CRC. [EOS]
Endpoint(s): Safety: • TEAEs [All visits] • Vital signs (blood pressure, pulse) [EOT, ET] • Clinical laboratory testing (hematology, serum chemistry, and urinalysis) [EOT, ET] • Ocular pain assessment (FACES) [All visits] • Visual acuity (ETDRS BCDVA) [All visits] • Slit lamp examination [All visits] • NEI grading scale for corneal fluorescein staining [All visits] • Dilated fundus ophthalmoscopy [EOS, ET], Efficacy: • The proportion of subjects achieving corneal re-epithelialization that is maintained for a minimum of 28 days, based on assessment of corneal fluorescein staining of the PCED by the Investigator. [EOS] • The proportion of subjects achieving corneal re-epithelialization, based on assessment of corneal fluorescein staining images of the PCED by a CRC. [EOT], Efficacy: • The proportion of subjects achieving corneal re-epithelialization based on assessment of corneal fluorescein staining images of the PCED by Investigator. [EOT] • The number of dose administrations subjects required to achieve corneal re-epithelialization that is maintained for a minimum of 28 days after completing treatment, based on assessment of corneal fluorescein staining images of the PCED by a CRC. [EOS], Efficacy: • The number of dose administrations subjects required to achieve corneal re-epithelialization that is maintained for a minimum of 28 days after completing treatment, based on assessment of corneal fluorescein staining images of the PCED by Investigator. [EOS], Efficacy: • The time (in days) to corneal re-epithelialization, defined as the time from randomization to the time of corneal re-epithelialization based on assessment of corneal fluorescein staining images of the PCED by a CRC. [All visits]. • The time (in days) to corneal re-epithelialization, defined as the time from randomization to the time of corneal re-epithelialization based on assessment of corneal fluorescein staining images of the PCED by Investigator. [All visits]., Efficacy • The mean change from baseline (CFB) in ocular pain based on OPAS. [EOS] • The mean CFB in BCDVA (ETDRS). [EOS] • The proportion of subjects who achieve a 15 letter (ETDRS) gain in BCDVA. [EOS] • The proportion of subjects requiring open-label treatment during the Treatment Period. [EOT], Efficacy • The proportion of subjects in the Open-Label Treatment Period that achieve re-epithelialization of the corneal epithelial defect that remains durable for a minimum of 28 days based on the CRC assessment on images. [Open-Label EOS], Exploratory: • The mean percentage CFB in corneal neuronal sensitivity. [EOS] • The evaluation of the CFB in MMP-9 levels in subjects tear fluid. [EOS] • The portion of subjects who experience loss of epithelium due to the removal of the bandage contact lens (BCL). [All visits]

Source: https://euclinicaltrials.eu/ctis-public/view/2023-507030-24-00